EU clinical trial 2024-515667-60-00: An exploratory, multicenter, randomized, open-label with blind evaluation, active-controlled study to evaluate the safety and efficacy of Keramod® (imiquimod 50 mg/g, Gel) compared with Aldara® (imiquimod 50 mg/g, Cream) for the treatment of actinic keratosis in adults.
Protocol code: OJ-KDC01
Sponsor: Laboratorios Ojer Pharma S.L. (Pharmaceutical company). Phase: Therapeutic exploratory (Phase II). Countries: Spain (ongoing, recruitment ended).
Therapeutic area(s): Diseases [C] - Skin and Connective Tissue Diseases [C17]
Gender: Female, Male. Age: 18-64 years, 65+ years. Enrolment: 68.
Status: Ongoing, recruitment ended. Start date (EU): 2020-01-14. Decision date: 2024-09-20. Results received: No. Last updated: 2025-06-23.

Condition(s): Actinic keratosis
Product: ALDARA 5% cream, Keramod® gel

Primary endpoint: Complete clearance of AK lesions, defined as a count of zero AK lesions at week 24 since the first treatment dose.
Endpoint(s): 1. Partial and complete clearance rate of AK lesions at the end of first and second cycles: Week 8 (end of first cycle treatment period; visit 3) and Week 16 (end of second cycle treatment period; visit 5)., 2. Tolerance and acceptability of the treatment by the study subject assessed by the Treatment tolerance and satisfaction questionnaire., 3. Evaluation of adherence by Treatment Adherence Questionnaire., 4. Rate of subjects who complete one treatment cycle., 5. Rate of subjects who complete two treatment cycles., 6. Severity and frequency of associated adverse events/serious adverse events (AEs/SAEs).

Source: https://euclinicaltrials.eu/ctis-public/view/2024-515667-60-00